EU clinical trial 2023-506210-40-00: A Phase 3, Single-arm, Open-label Extension of the Vericiguat VALOR Study in Pediatric Participants with Heart Failure due to Systemic Left Ventricular Systolic Dysfunction (VALOR EXT)
Protocol code: MK-1242-043
Sponsor: Merck Sharp & Dohme LLC (Pharmaceutical company). Phase: Therapeutic confirmatory (Phase III). Countries: Italy (ended), Portugal (ended), Sweden (ended), Denmark (ended), Poland (ended), Belgium (ended), Spain (ended), Netherlands (ended), Ireland (ended), Hungary (ended), Germany (ended), Finland (ended), France (ended).
Therapeutic area(s): Diseases [C] - Cardiovascular Diseases [C14]
Gender: Female, Male. Age: 0-17 years, 18-64 years. Enrolment: 99.
Status: Ended. Start date (EU): 2024-06-28. End date (EU): 2025-06-24. End date: 2025-08-15. Decision date: 2024-03-12. Results received: Yes. Last updated: 2025-04-23.
Decision dates by country: BE: 2024-03-18, DK: 2024-03-12, FR: 2024-03-13, DE: 2024-03-12, HU: 2024-03-18, IT: 2024-03-21, PT: 2024-03-13, ES: 2024-03-15, SE: 2024-03-13, NL: 2024-03-12, PL: 2024-03-20, FI: 2024-03-18, IE: 2024-03-15

Condition(s): Heart Failure due to Systemic Left Ventricular Systolic Dysfunction
Product: Vericiguat, Vericiguat, Vericiguat, Vericiguat

Primary endpoint: Number of Participants Who Experience an Adverse Event (AE), Number of Participants Who Discontinue Study Treatment Due to an AE
Endpoint(s): Change from baseline to Week 16 in N-terminal pro-brain natriuretic peptide (NT-proBNP)

Source: https://euclinicaltrials.eu/ctis-public/view/2023-506210-40-00